EU clinical trial 2023-505086-83-00: A Double-blind, Placebo-controlled, Phase IIb, Multi-center, Twelve-week Prospective Study to Evaluate the Efficacy and Safety of Gemlapodect in Adult and Adolescent Patients with Tourette Syndrome – Allevia 2
Protocol code: NOE-TTS-201
Sponsor: Noema Pharma AG (Pharmaceutical company). Phase: Therapeutic exploratory (Phase II). Countries: Spain (ended), France (ended), Poland (ended), Hungary (ended), Belgium (ended), Germany (ended).
Therapeutic area(s): Diseases [C] - Nervous System Diseases [C10]
Gender: Female, Male. Age: 0-17 years, 18-64 years, 65+ years. Enrolment: 130.
Status: Ended. Start date (EU): 2024-07-10. End date (EU): 2026-01-15. End date: 2026-02-12. Decision date: 2024-03-05. Results received: No. Last updated: 2026-07-27.
Decision dates by country: DE: 2024-04-19, FR: 2024-03-11, BE: 2024-03-08, ES: 2024-04-19, HU: 2024-03-11, PL: 2024-03-08

Condition(s): Tourette Syndrome
Product: NOE-105, Placebo, Hard Capsules

Primary endpoint: Change in YGTSS-R total tic scores from baseline (randomization) to D85 for gemlapodect as compared to placebo
Endpoint(s): Change in SDS from baseline (randomization) to D85 for gemlapodect as compared to placebo, Change in TS-CGI-S scale from baseline (randomization) to D85 for gemlapodect as compared to placebo, TS-CGI-C scale at D85 for gemlapodect as compared to placebo, PGI-C scale at D85 for gemlapodect as compared to placebo, Change in PUTS from baseline (randomization) to D85 for gemlapodect as compared to placebo, Change in ADHD-RS from baseline (randomization) to D85 for gemlapodect as compared to placebo, Change in C&A-GTS-QOL subscale from baseline (randomization) to D85 for gemlapodect as compared to placebo, Change in body weight and effect on blood glucose and lipids, Incidence and severity of AEs, including SAEs and AESI, Laboratory assessments, ECG assessment, Assessment of vital signs, Suicidality assessed by C-SSRS, Plasma concentrations of gemlapodect, Assessment of bodyweight changes over time from baseline

Source: https://euclinicaltrials.eu/ctis-public/view/2023-505086-83-00